EU clinical trial 2024-519351-28-00: Validation of ICG-99mTc-nanoscan as hybrid tracer for sentinel node biopsy - NANOSCAN
Sponsor: Het Nederlands Kanker Instituut-Antoni van Leeuwenhoek Ziekenhuis Stichting (Hospital/Clinic/Other health care facility). Phase: Therapeutic exploratory (Phase II). Countries: Netherlands (ended).
Therapeutic area(s): Diseases [C] - Neoplasms [C04]
Gender: Female, Male. Age: 18-64 years, 65+ years. Enrolment: 29.
Status: Ended. Start date (EU): 2023-11-15. End date (EU): 2025-07-14. Decision date: 2024-12-16. Results received: No. Last updated: 2024-12-16.

Condition(s): Patients with melanoma of the head/neck or the upper part of the trunk, oral malignancies or penile carcinoma who are scheduled for a sentinel node (SN) biopsy.
Product: INDOCYANINE GREEN, TECHNETIUM (99MTC) NANOCOLLOID, TECHNETIUM (99MTC) NANOCOLLOID

Primary endpoint: To demonstrate concordance between the SN visualization of 99mTc-nanoscan and ICG-99mTc-nanoscan on preoperative lymphoscintigraphy and SPECT/CT imaging, expecting an average of 3 sentinel nodes per patient. Discordance is defined as more than 1 sentinel node not detected coherently by the tracers.
Endpoint(s): Number of higher-echelon nodes visualized on preoperative lymphoscintigraphy and SPECT/CT imaging for both tracers (ICG-99mTc-Nanoscan and 99mTc-Nanoscan); 99mTc-Nanoscan is used as reference tracer., Concordance between intraoperative fluorescence and radioactive findings, using: • Number and intensity of the fluorescent nodes at time of excision; • Number and radioactive signal intensity of the radioactive nodes at time of excision

Source: https://euclinicaltrials.eu/ctis-public/view/2024-519351-28-00